EU clinical trial 2025-521634-29-00: A Randomized, Open-labelled, Multicenter Trial Evaluating Efficacy and Safety of A Reduced Venetoclax Exposure To Seven Days Versus Standard Continuous Venetoclax Exposure Combined With Azacitidine in Treatment Naïve Subjects with Acute Myeloid Leukemia Who Are Ineligible for Intensive Induction (SEVENAZA)
Protocol code: CSET 2025/4132
Sponsor: Institut Gustave Roussy (Hospital/Clinic/Other health care facility). Phase: Therapeutic confirmatory (Phase III). Countries: France (ongoing, recruiting), Spain (ongoing, recruiting).
Therapeutic area(s): Diseases [C] - Hemic and Lymphatic Diseases [C15]; Diseases [C] - Immune System Diseases [C20]
Gender: Female, Male. Age: 65+ years. Enrolment: 262.
Status: Ongoing, recruiting. Start date (EU): 2026-03-02. Decision date: 2026-02-11. Results received: No. Last updated: 2026-04-07.
Decision dates by country: FR: 2026-02-11, ES: 2026-02-13

Condition(s): Acute Myeloid Leukemia, ONCOLOGY
Product: Vidaza 25 mg/ml powder for suspension for injection, Venclyxto 100 mg film-coated tablets

Primary endpoint: The proportion of subjects with complete remission or complete remission with incomplete marrow recovery (CR/CRi) will be calculated based on current IWG criteria for AML (Cheson et al J Clin Oncol 2003)
Endpoint(s): Overall survival (OS). Event-Free Survival (EFS)., Early mortality rate at Day 60., Time to first response. Time to best response., Duration of response (DoR)., Health-Related Quality of Life (HRQoL) assessed by the EORTC QLQ-ELD14 and EuroQol EQ-5D-5L questionnaires, Scheme modification will be defined as the proportion of CR/CRi patients that presented treatment modification not authorized by protocol as VEN schedule modification (dose, duration), delay >2 days from the initial Day of the subsequent cycle and/or temporary/definitive VEN discontinuation., Toxicity evaluated by platelet transfusion, febrile neutropenia or severe infection episodes, hospitalization requirement and hospitalization length stay, Incremental costs and QALY and ICER (€/QALY) (only for included patients treated in France)

Source: https://euclinicaltrials.eu/ctis-public/view/2025-521634-29-00